EU clinical trial 2022-500974-33-00: Best Antithrombotic Therapy in patients with acute Venous ThromboEmbolism while taking antiplatelets: the BAT-VTE
Protocol code: 20PH285
Sponsor: Centre Hospitalier Universitaire De Saint Etienne (Hospital/Clinic/Other health care facility). Phase: Therapeutic confirmatory (Phase III). Countries: France (ongoing, recruiting).
Therapeutic area(s): Diseases [C] - Cardiovascular Diseases [C14]
Gender: Female, Male. Age: 18-64 years, 65+ years. Enrolment: 1400.
Status: Ongoing, recruiting. Start date (EU): 2023-08-12. Decision date: 2023-04-04. Results received: No. Last updated: 2026-07-10.

Condition(s): acute venous thromboembolism event
Product: HEPARINE CHOAY 5 000 UI/1 ml, solution injectable, SINTROM 4 mg, comprimé quadrisécable, Xarelto 10 mg film-coated tablets, RESITUNE 100 mg, comprimé gastro-résistant, LOVENOX 10 000 UI (100 mg)/1 ml, solution injectable en seringue préremplie, SINTROM 4 mg, comprimé quadrisécable, CALCIPARINE SOUS CUTANEE 20 000 UI/0,8 ml, solution injectable, LOVENOX 10 000 UI (100 mg)/1 ml, solution injectable en seringue préremplie, HEPARINE CHOAY 25 000 UI/5 ml, solution injectable, Arixtra 7.5 mg/0.6 ml solution for injection, pre-filled syringe., INNOHEP 10 000 UI anti-Xa/0,5 ml, solution injectable en seringue préremplie, FRAGMINE 10 000 U.l. anti Xa/1 ml, solution injectable en seringue pré-remplie, COUMADINE 2 mg, comprimé sécable, KARDEGIC 75 mg, poudre pour solution buvable en sachet-dose, Arixtra 7.5 mg/0.6 ml solution for injection, pre-filled syringe., COUMADINE 5 mg, comprimé sécable, Eliquis 5 mg film-coated tablets, Xarelto 15 mg film-coated tablets, CALCIPARINE SOUS CUTANEE 12 500 UI/0,5 ml, solution injectable, FRAGMINE 7 500 U.l. anti Xa/0,75 ml, solution injectable en seringue pré-remplie, INNOHEP 4 500 UI anti-Xa/0,45 ml, solution injectable en seringue préremplie, Plavix 75 mg film-coated tablets, Eliquis 5 mg film-coated tablets

Primary endpoint: Clinically relevant bleeding (=composite of major bleeding events and clinically relevant non-major bleeding events (according to the ISTH)) at the end of the full-dose treatment period (or up to 12 months).
Endpoint(s): o Net clinical benefit is defined by the composite of clinically relevant bleeding, recurrent venous thromboembolism and major adverse ischemic cardiovascular and cerebrovascular events, at the end of the full-dose treatment period, or up to 12 months, o Clinically relevant bleeding, o Major bleeding, o Vascular events are the composite of recurrent venous thromboembolism, major adverse cardiovascular and cerebrovascular events, o VTE sequels are the composite of post-thrombotic syndrome and/or post-PE syndrome

Source: https://euclinicaltrials.eu/ctis-public/view/2022-500974-33-00